EU clinical trial 2024-518039-12-00: A Phase 1 Study to Determine the Safety, Tolerability and Pharmacokinetics of 177Lu-EVG321 in Patients with Small Cell Lung Cancer
Protocol code: EVG001AT101
Sponsor: Evergreen Theragnostics Inc. (Pharmaceutical company). Phase: Human Pharmacology (Phase I)- First administration to humans. Countries: Austria (temporarily halted), Italy (authorised, recruitment pending).
Therapeutic area(s): Diseases [C] - Neoplasms [C04]
Gender: Female, Male. Age: 18-64 years, 65+ years. Enrolment: 20.
Start date (EU): 2025-05-27. Decision date: 2025-02-05. Results received: No. Last updated: 2026-08-05.
Decision dates by country: AT: 2025-04-14, IT: 2025-04-09

Condition(s): Small Cell Lung Cancer

Source: https://euclinicaltrials.eu/ctis-public/view/2024-518039-12-00